EU clinical trial 2024-520234-30-00: A randomized, double-blind, placebo-controlled, multicenter study evaluating the effect of a 12-week DHEA combination of 20 mg and 2 mg prolonged-release melatonin on sleep quality and mood in postmenopausal women.
Protocol code: DHM/EPH/01/2022
Sponsor: The Pharmaceutical Company LEK-AM Sp. Zoo., Przedsiebiorstwo Farmaceutyczne Lek-Am Sp. z o.o. (Industry, Pharmaceutical company). Phase: Therapeutic confirmatory (Phase III). Countries: Poland (ongoing, recruiting).
Therapeutic area(s): Diseases [C] - Female Urogenital Diseases and Pregnancy Complications [C13]; Health Care [N] - Health Care Quality, Access, and Evaluation [N05]
Gender: Female. Age: 18-64 years, 65+ years. Enrolment: 100.
Status: Ongoing, recruiting. Start date (EU): 2024-11-30. Decision date: 2025-01-30. Results received: No. Last updated: 2025-05-13.

Condition(s): Menopause, sleep disorders in the postmenopausal period
Product: Biosteron, 10 mg, tabletki, Senaxa PR, 2 mg, tabletki o przedłużonym uwalnianiu

Primary endpoint: The primary endpoints of this study are to evaluate the effects of 12 weeks of DHEA 20 mg and 2 mg sustained-release melatonin on sleep quality in postmenopausal women and on mood and reduction of menopausal vasomotor symptoms.
Endpoint(s): Assessment of the effect of 12-week administration of DHEA in a dose of 20 mg and 2 mg of sustained-release melatonin on the serum concentration of DHEAS, estradiol, LH and SHBG.

Source: https://euclinicaltrials.eu/ctis-public/view/2024-520234-30-00